EU clinical trial 2024-516959-40-00: A randomized phase II trial of Mirvetuximab soravtansine (IMGN853), in folate receptor alpha (FRα) high recurrent ovarian cancer eligible for platinum-based chemotherapy. supported by: DIAGNOSTIC PROTOCOL for the VENTANA FOLR1 (FOLR1-2.1) CDx Assay Ventana No. RD004881; Protocol Document No. D152967
Protocol code: AGO-OVAR 2.34
Sponsor: AGO Research GmbH (Pharmaceutical company). Phase: Therapeutic exploratory (Phase II). Countries: Germany (ongoing, recruitment ended).
Therapeutic area(s): Diseases [C] - Neoplasms [C04]
Gender: Female. Age: 18-64 years, 65+ years. Enrolment: 136.
Status: Ongoing, recruitment ended. Start date (EU): 2021-08-17. Decision date: 2024-11-08. Results received: No. Last updated: 2026-06-08.

Condition(s): This trial evaluates the efficacy and safety of Mirvetuximab soravtansine (IMGN853) plus Carboplatin chemotherapy in FRα high patients with recurrent ovarian cancer who are eligible for platinum-based chemotherapy.
Product: Paclitaxel-GRY® 6 mg/ml Konzentrat zur Herstellung einer Infusionslösung, Lynparza 150 mg film-coated tablets, Gemcitabin-GRY 1000 mg Pulver zur Herstellung einer Infusionslösung, Rubraca 300 mg film-coated tablets, MIRVETUXIMAB SORAVTANSINE, Zejula 100 mg film-coated tablets, Caelyx pegylated liposomal 2 mg/ml concentrate for solution for infusion, Carboplatin Kabi 10 mg/ml Konzentrat zur Herstellung einer Infusionslösung

Primary endpoint: Progression free survival (PFS) defined as the time from randomization to progressive disease (PD) or death, whichever occurs earlier.
Endpoint(s): Overall survival (OS), defined as the time from randomization to death from any cause., Objective Response Rate (ORR), Efficacy regarding PFS, OS and ORR depending on histologic subtype., Time to serological progressive disease according to GCIG criteria., Time to first subsequent treatment (TFST), Time to second subsequent treatment (TSST), Patient-reported outcomes: Quality of Life (EORTC C-30, OV28), Safety and tolerability of the used drugs evaluated by NCI CTCAE v5.0, records of dose reductions, delays, or interruptions.

Source: https://euclinicaltrials.eu/ctis-public/view/2024-516959-40-00